EU clinical trial 2023-506794-35-00: Master Protocol of Sotorasib (AMG 510) in Subjects with Advanced Solid Tumors With KRAS p.G12C Mutation (CodeBreaK 101)
Protocol code: 20190135
Sponsor: Amgen Inc. (Pharmaceutical company). Phase: Human Pharmacology (Phase I)- Other. Countries: Netherlands (ongoing, recruitment ended), Germany (ongoing, recruitment ended), Belgium (ongoing, recruitment ended), Austria (ended), Italy (ongoing, recruitment ended), Spain (ongoing, recruitment ended).
Therapeutic area(s): Diseases [C] - Neoplasms [C04]
Gender: Female, Male. Age: 18-64 years, 65+ years. Enrolment: 136.
Start date (EU): 2022-04-01. Decision date: 2024-09-11. Results received: No. Last updated: 2026-02-06.
Decision dates by country: ES: 2024-09-16, DE: 2024-09-12, BE: 2024-09-16, AT: 2024-09-20, NL: 2024-09-11, IT: 2024-10-02

Condition(s): Advanced Solid Tumors Kirsten Rat Sarcoma (KRAS) pG12C Mutation

Source: https://euclinicaltrials.eu/ctis-public/view/2023-506794-35-00